EU clinical trial 2025-524730-26-00: IMPD-Q-only application
Sponsor: Incyte Corp. (Pharmaceutical company). Phase: Human Pharmacology (Phase I)- Other. Countries: Austria (not authorised).
Therapeutic area(s): Diseases [C] - Skin and Connective Tissue Diseases [C17]
Gender: Female, Male. Age: 18-64 years, 65+ years. Enrolment: 30.
Status: Not authorised. Decision date: 2026-06-01. Results received: No. Last updated: 2026-06-01.

Condition(s): prick test-induced itch

Source: https://euclinicaltrials.eu/ctis-public/view/2025-524730-26-00